EU clinical trial 2024-512380-32-00: A Phase 1 Study of PRT7732, an Oral SMARCA2 Degrader, in Patients with Advanced or Metastatic Solid Tumors with a SMARCA4 Mutation
Protocol code: PRT7732-01
Sponsor: Prelude Therapeutics Inc. (Pharmaceutical company). Phase: Human Pharmacology (Phase I)- First administration to humans. Countries: Germany (ended), Spain (ended).
Therapeutic area(s): Diseases [C] - Neoplasms [C04]
Gender: Female, Male. Age: 18-64 years, 65+ years. Enrolment: 16.
Status: Ended. Start date (EU): 2025-03-03. End date (EU): 2025-11-26. End date: 2026-01-28. Decision date: 2025-01-21. Results received: No. Last updated: 2025-10-07.
Decision dates by country: ES: 2025-01-21, DE: 2025-01-22

Condition(s): esophageal, gastric, or gastroesophageal junction adenocarcinoma, esophageal, gastric, or gastroesophageal junction squamous cell carcinoma, Non-small cell lung cancer (NSCLC), Advanced or Metastatic Solid Tumors with a SMARCA4 Mutation

Source: https://euclinicaltrials.eu/ctis-public/view/2024-512380-32-00